EU clinical trial 2023-506817-23-01: EORTC-2238-GUCG: Intermittent Androgen deprivation Therapy in the era of AR pathway inhibitors; a phase 3 pragmatic randomized trial (DE-ESCALATE)
Protocol code: EORTC-2238-GUCG
Sponsor: European Organisation For Research And Treatment Of Cancer (Patient organisation/association). Phase: Therapeutic confirmatory (Phase III). Countries: Belgium (ongoing, recruiting), Ireland (ongoing, recruiting), Croatia (ongoing, recruiting), Spain (ongoing, recruiting), France (ongoing, recruiting), Denmark (ongoing, recruiting), Slovenia (authorised, recruitment pending), Romania (authorised, recruitment pending), Italy (authorised, recruiting), Czechia (authorised, recruitment pending).
Therapeutic area(s): Diseases [C] - Male Urogenital Diseases [C12]
Gender: Male. Age: 18-64 years, 65+ years. Enrolment: 1404.
Start date (EU): 2025-05-23. Decision date: 2025-04-01. Results received: No. Last updated: 2026-06-08.
Decision dates by country: HR: 2025-04-04, FR: 2025-04-02, DK: 2025-04-01, SI: 2026-06-02, RO: 2026-06-08, IT: 2026-05-29, BE: 2025-04-01, CZ: 2026-04-29, ES: 2025-04-03, IE: 2025-04-04

Condition(s): Metastatic hormone naïve prostate cancer (mHNPC)
Product: ABIRATERONE, RELUGOLIX, DAROLUTAMIDE, APALUTAMIDE, LEUPRORELIN, TRIPTORELIN, ENZALUTAMIDE, GOSERELIN, DEGARELIX

Primary endpoint: The co-primary endpoints in this trial are: 1) Proportion of patients who do not restart their hormonal therapy within 1 year of interrupting their MAB therapy 2) Overall survival (from randomization)
Endpoint(s): Safety according to the CTCAE (NCI Common Terminology Criteria for Adverse Events) Version 5.0 for toxicity of grade 3 or higher Adverse Events, Adverse Events of Special Interest, and Serious Adverse Event reporting, The magnitude of change from baseline to 1 year in HRQoL in terms of physical functioning from the EORTC QLQ-C30, and sexual activity, pain and physical fatigue from the IL249 item list, Time spent on MAB treatment, Time to next systemic prostate cancer therapy, Health utility derived from patient reported QLQ-C30 data and patient demographics, The magnitude of change in HRQoL in terms of physical functioning from EORTC QLQ-C30, and sexual activity, pain characteristics and physical fatigue from the IL249 item list, from baseline to three years, Change in HRQoL in terms of the pain and emotional functioning and cognitive functioning scales of EORTC QLQ-C30, and hormonal treatment-related symptoms scale of EORTC IL249 among patients treated with iMAB compared to those on continuous treatment from baseline to one year and three years, Change in HRQoL in terms the remaining scales the EORTC QLQ-C30 and IL249 among patients treated with iMAB compared to those on continuous treatment from baseline to one year and three years, Evolution of HRQoL in terms of all the scales from EORTC QLQ-C30 and EORTC IL249 among patients in the iMAB and cMAB arms respectively, OS and prostate cancer specific survival from start of MAB treatment, Proportion of patients with recovered testosterone levels (testosterone > 150 ng/dL) at 1 and 3 years after interrupting their MAB therapy, Proportion of patients with PSA ≤ 0.2 ng/mL at 3 years after interrupting their MAB therapy, Testosterone and PSA value profiles during the first 3 years, Prostate cancer specific survival, Enrolment rates via screening log and patient accrual.

Source: https://euclinicaltrials.eu/ctis-public/view/2023-506817-23-01